EU clinical trial 2025-524258-32-00: A study of the safety, tolerability, pharmacokinetics and preliminary efficacy of TNV108 in healthy adults and patients with diabetic peripheral neuropathy
Protocol code: TNV108
Sponsor: Tenvie Therapeutics Inc. (Laboratory/Research/Testing facility). Phase: Human Pharmacology (Phase I)- First administration to humans. Countries: Netherlands (ongoing, recruiting).
Therapeutic area(s): Phenomena and Processes [G] - Musculoskeletal and Neural Physiological Phenomena [G11]; Diseases [C] - Nervous System Diseases [C10]
Gender: Female, Male. Age: 18-64 years. Enrolment: 108.
Status: Ongoing, recruiting. Start date (EU): 2026-03-02. Decision date: 2026-02-24. Results received: No. Last updated: 2026-02-24.

Condition(s): Diabetic Peripheral Neuropathy (DPN)

Source: https://euclinicaltrials.eu/ctis-public/view/2025-524258-32-00